EU clinical trial 2023-503676-25-01: Progression under Olaparib: a randomized phaSE II trIal with docetaxel or carboplatin-docetaxel DOublet in mCRPC patieNts
Protocol code: POSEIDON
Sponsor: Azienda Provinciale Per I Servizi Sanitari (Hospital/Clinic/Other health care facility). Phase: Therapeutic exploratory (Phase II). Countries: Italy (authorised, recruitment pending).
Therapeutic area(s): Diseases [C] - Neoplasms [C04]
Gender: Male. Age: 18-64 years, 65+ years. Enrolment: 157.
Status: Authorised, recruitment pending. Decision date: 2024-11-18. Results received: No. Last updated: 2024-11-18.

Condition(s): prostate cancer
Product: DEXAMETHASONE, CHLORPHENAMINE, Carboplatino Hikma 10 mg/ml soluzione per infusione, LEUPRORELIN, TRIPTORELIN, LOPERAMIDE, Docetaxel Accord 20 mg/1 ml concentrate for solution for infusion, DEGARELIX, GOSERELIN, FILGRASTIM

Primary endpoint: Rate of patients without disease progression after 4 months from the treatment start according to PCWG3
Endpoint(s): Progression free-survival by Kaplan-Meier method, Overall survival by Kaplan-Meier method, Biochemical response rate, Objective response rate according to RECIST criteria, Adverse events type and grade according to CTCAE v.5, Scales of FACT-P and BPI questionnaires

Source: https://euclinicaltrials.eu/ctis-public/view/2023-503676-25-01